EU clinical trial 2024-516779-33-00: Phase Ib/II non-randomized non-comparative two-cohort study of Niraparib and Dostarlimab plus (Chemo)RadIotherapy in Locally-Advanced head and Neck squamous cell carcinoma (RADIAN)
Protocol code: TTCC-2022-01-RADIAN
Sponsor: Grupo Espanol De Tratamiento De Tumores De Cabeza Y Cuello (Hospital/Clinic/Other health care facility). Phase: Phase I and Phase II (Integrated)- Other. Countries: Spain (ongoing, recruitment ended).
Therapeutic area(s): Diseases [C] - Neoplasms [C04]
Gender: Female, Male. Age: 18-64 years, 65+ years. Enrolment: 34.
Status: Ongoing, recruitment ended. Start date (EU): 2023-11-08. Decision date: 2024-08-27. Results received: No. Last updated: 2026-03-05.

Condition(s): Carcinoma
Product: Zejula 100 mg film-coated tablets, JEMPERLI 500 mg concentrate for solution for infusion

Primary endpoint: 1-year disease free survival
Endpoint(s): ● Treatment-related adverse events (TRAEs) as per NCI CTCAE v5.0. ● Rate of completion of niraparib during the neoadjuvant phase. ● Rate of disease progression as per clinical examination per treating physician during neoadjuvant phase. ● Rate of radiotherapy completion. ● Rate of completion of the maintenance phase of the study, ● Locoregional control at 12, 18 and 24 months ● Distant control at 12, 18 and 24 months ● Event-free survival ● Overall survival, ● Correlation between levels of circulating tumor DNA (ctDNA) clearance at post-treatment timepoints and 1-year disease-free survival in patients with positive/detectable ctDNA at baseline. ● Correlation of ctDNA dynamics (increase/decrease) across timepoints: Pre first dose dostarlimab (Day -21); Pre first dose niraparib (Day -14); Pre radiotherapy; At cycle 4 of maintenance; EOT and/or PD, and 1-year disease-free survival and secondary outcomes.

Source: https://euclinicaltrials.eu/ctis-public/view/2024-516779-33-00